EU clinical trial 2024-514154-73-00: A randomized controlled trial to compare the immunogenicity and skin imprinting of intradermal, subcutaneous and intramuscular yellow fever vaccination
Sponsor: Institute Of Tropical Medicine (Hospital/Clinic/Other health care facility). Phase: Therapeutic confirmatory (Phase III). Countries: Belgium (ongoing, recruiting).
Therapeutic area(s): Diseases [C] - Virus Diseases [C02]
Gender: Female, Male. Age: 18-64 years. Enrolment: 222.
Status: Ongoing, recruiting. Start date (EU): 2025-01-02. Decision date: 2024-09-13. Results received: No. Last updated: 2025-07-24.

Condition(s): Yellow fever
Product: STAMARIL® , poeder en oplosmiddel voor suspensie voor injectie in voorgevulde spuit. Gelekoortsvaccin (levend)., STAMARIL® , poeder en oplosmiddel voor suspensie voor injectie in voorgevulde spuit. Gelekoortsvaccin (levend)., STAMARIL® , poeder en oplosmiddel voor suspensie voor injectie in voorgevulde spuit. Gelekoortsvaccin (levend).

Primary endpoint: The percentage of YFV-specific T cells within the skin-resident lymphocyte parent population at D28, measured by flow cytometry., The absolute number of YFV-specific T cells within the skin-resident lymphocyte parent population at D28, measured by flow cytometry.
Endpoint(s): Percentage and absolute number of circulating and YFV-specific TCM and TEM cells within the CD3+ lymphocyte parent population at D28, and increase in their percentage and absolute number from D0 to D28., Percentage and absolute number of YFV-specific TRM, TCM and TEM CD4+ and CD8+ T cells within the skin-resident or CD3+ lymphocyte parent population at D28., The serum dilutions at which 50% viral neutralization occurs (NT50) as measured by the certified VNT (virus neutralization test) assays at D28, and the increase in their percentage and absolute number from D0 to D28., The nAbs NT50 titres, IFNy+ spot forming units (SFU) and IFNy/TNF-a/IL-2+ SFU at D0, D14, D28 and D120 measured by VNT and ELISpot/fluorospot respectively., At all timepoints, the NT50 of VNT testing and IFNy+ spot forming units (SFU) and IFNy/TNF-a/IL-2+ SFU. In addition at D0 and D28 , the percentage and absolute number of YFV-specific TRM, TCM and TEM cells within the CD3+ lymphocyte parent population., The occurrence of solicited and unsolicited local Adverse Events (AEs) [Up to Day 28 after vaccination], The occurrence of solicited and unsolicited systemic AEs [Up to Day 28 after vaccination], The occurrence of Serious Adverse Events (SAE’s) [Up to D120], The occurrence of solicited and unsolicited local Adverse Events (AEs) [Up to Day 28 after vaccination], The occurrence of solicited and unsolicited systemic AEs [Up to Day 28 after vaccination], The absolute number of YFV-specific TRM, TCM and TEM cells at D28

Source: https://euclinicaltrials.eu/ctis-public/view/2024-514154-73-00